EU clinical trial 2024-516158-22-00: A Phase II, Multicenter, Open-label Study to Evaluate the Efficacy and Safety of Trastuzumab Deruxtecan (T-DXd) for the Treatment of Unresectable and/or Metastatic Solid Tumors Harboring HER2 Activating Mutations Regardless of Tumor Histology
Protocol code: D967MC00001
Sponsor: AstraZeneca AB (Pharmaceutical company). Phase: Therapeutic exploratory (Phase II). Countries: Denmark (ended), France (ongoing, recruitment ended).
Therapeutic area(s): Diseases [C] - Neoplasms [C04]
Gender: Female, Male. Age: 18-64 years, 65+ years. Enrolment: 2.
Start date (EU): 2021-07-06. Decision date: 2024-07-25. Results received: No. Last updated: 2026-07-20.
Decision dates by country: DK: 2024-07-25, FR: 2024-08-19

Condition(s): Treatment of unresectable and/or metastatic solid tumors harboring specific HER2 activating mutations regardless of tumor histology
Product: DS-8201a

Primary endpoint: Confirmed objective response rate by RECIST v1.1 based on independent central review (ICR).
Endpoint(s): 1) Duration of response (DoR) based on ICR assessment., 2) Disease control rate (DCR) based on ICR assessment., 3) Progression free survival (PFS) based on ICR assessment., 4) Confirmed Objective Response Rate (ORR) based on investigator assessment., 5) Overall survival (OS)., 6) Occurrence of adverse events (AEs) and serious adverse events (SAEs)., 7) Pharmacokinetics (PK) assessed by serum concentration of T-DXd, total anti-HER2 antibody and MAAA-1181., 8) The immunogenicity of T-DXd assessed by the presence of ADAs for T-DXd.

Source: https://euclinicaltrials.eu/ctis-public/view/2024-516158-22-00